EU clinical trial 2024-511128-15-00: A8081075 - CRIZOTINIB MASTER PROTOCOL: AN OPEN-LABEL CONTINUATION STUDY FOR PARTICIPANTS CONTINUING FROM PFIZER-SPONSORED CRIZOTINIB CLINICAL STUDIES
Protocol code: A8081075
Sponsor: Pfizer Inc. (Pharmaceutical company). Phase: Therapeutic use (Phase IV). Countries: Italy (ongoing, recruiting).
Therapeutic area(s): Diseases [C] - Neoplasms [C04]
Gender: Female, Male. Age: 18-64 years. Enrolment: 5.
Status: Ongoing, recruiting. Start date (EU): 2023-01-17. Decision date: 2024-05-24. Results received: No. Last updated: 2025-10-27.

Condition(s): This Master Protocol for Crizotinib Continuation Sub-Studies has been designed to provide continued treatment access for eligible participants who continue to derive clinical benefit from study intervention in a Pfizer sponsored crizotinib parent study that will be closed
Product: XALKORI 200 mg hard capsules, XALKORI 250 mg hard capsules, Crizotinib 200 mg capsules, Crizotinib 250 mg capsules

Primary endpoint: AEs leading to permanent discontinuation of crizotinib, All SAEs

Source: https://euclinicaltrials.eu/ctis-public/view/2024-511128-15-00